EU clinical trial 2024-513262-19-00: An open-label, single-arm, multicenter study to evaluate the efficacy and safety of caplacizumab and immunosuppressive therapy without first-line therapeutic plasma exchange in adults with immunemediated thrombotic thrombocytopenic purpura
Protocol code: EFC16521
Sponsor: Sanofi-Aventis Recherche & Developpement (Pharmaceutical company). Phase: Therapeutic confirmatory (Phase III). Countries: Netherlands (ended), Czechia (ended), Spain (ended), Austria (ended), Italy (ended), Germany (ended), France (ended), Belgium (ended), Greece (ended).
Therapeutic area(s): Diseases [C] - Hemic and Lymphatic Diseases [C15]
Gender: Female, Male. Age: 18-64 years, 65+ years. Enrolment: 44.
Status: Ended. Start date (EU): 2022-11-21. End date (EU): 2024-11-06. End date: 2024-12-26. Decision date: 2024-07-11. Results received: Yes. Last updated: 2024-10-01.
Decision dates by country: AT: 2024-07-22, BE: 2024-07-18, CZ: 2024-07-16, FR: 2024-07-31, DE: 2024-07-12, GR: 2024-10-01, IT: 2024-07-16, ES: 2024-07-30, NL: 2024-07-11

Condition(s): Thrombotic Thrombocytopenic Purpura
Product: Cablivi 10 mg powder and solvent for solution for injection, Cablivi 10 mg powder and solvent for solution for injection, Cablivi 10 mg powder and solvent for solution for injection

Primary endpoint: Proportion of participants achieving Remission without requiring therapeutic plasma exchange (TPE).
Endpoint(s): Proportion of participants achieving Remission, Proportion of participants who require TPE, The occurrence of adverse events (AEs), serious adverse events (SAEs), and adverse events of special interest (AESIs), Proportion of participants achieving Clinical Response (On-treatment period from day 1 to day 84), Proportion of participants achieving Clinical Response (Overall study period from day 1 to day 168), Time to platelet count response, Proportion of participants refractory to therapy, Proportion of participants with TTP-related death (On-treatment period from day 1 to day 84), Proportion of participants with TTP-related death (Overall study period from day 1 to day 168), Proportion of participants with a clinical exacerbation of iTTP (On-treatment period from day 1 to day 84), Proportion of participants with a clinical exacerbation of iTTP (Overall study period from day 1 to day 168), Proportion of participants with a clinical relapse of iTTP (On-treatment period from day 1 to day 84), Proportion of participants with a clinical relapse of iTTP (Overall study period from day 1 to day 168)

Source: https://euclinicaltrials.eu/ctis-public/view/2024-513262-19-00